EU clinical trial 2023-507230-24-00: FIGO 2018 stage IB2 (>2 cm - ≤4 cm ) Cervical Cancer Treated with Neoadjuvant Chemotherapy Followed by Fertility Sparing Surgery (CoNteSSa) / Neo-Adjuvant Chemotherapy and Conservative Surgery in Cervical Cancer to Preserve Fertility (NeoCon-F)
Sponsor: University Health Network, Het Nederlands Kanker Instituut-Antoni van Leeuwenhoek Ziekenhuis Stichting (Hospital/Clinic/Other health care facility). Phase: Therapeutic exploratory (Phase II). Countries: Netherlands (ongoing, recruiting), Italy (authorised, recruitment pending).
Therapeutic area(s): Diseases [C] - Neoplasms [C04]
Gender: Female. Age: 18-64 years. Enrolment: 28.
Start date (EU): 2021-02-17. Decision date: 2023-09-22. Results received: No. Last updated: 2025-10-15.
Decision dates by country: NL: 2023-09-22, IT: 2024-07-12

Condition(s): Cervical cancer
Product: CISPLATIN, PACLITAXEL, CARBOPLATIN

Primary endpoint: To determine the rate of functional uterus defined as successful fertility sparing treatment (completion of neo-adjuvant chemotherapy (NACT) followed by fertility sparing surgery (FSS) and no adjuvant therapy)

Source: https://euclinicaltrials.eu/ctis-public/view/2023-507230-24-00